EU clinical trial 2025-520740-16-00: A Randomised, Double-Blind, Placebo-Controlled, Parallel-Group Study to Assess the Efficacy and Safety of Baxdrostat in Adult Participants with Primary Aldosteronism
Protocol code: D6974C00001
Sponsor: AstraZeneca AB (Pharmaceutical company). Phase: Therapeutic confirmatory (Phase III). Countries: Germany (ongoing, recruitment ended), Italy (ongoing, recruitment ended), France (ongoing, recruitment ended), Spain (ongoing, recruitment ended).
Therapeutic area(s): Diseases [C] - Cardiovascular Diseases [C14]
Gender: Female, Male. Age: 18-64 years, 65+ years. Enrolment: 49.
Status: Ongoing, recruitment ended. Start date (EU): 2025-09-19. Decision date: 2025-08-14. Results received: No. Last updated: 2026-05-26.
Decision dates by country: ES: 2025-08-19, IT: 2025-08-21, DE: 2025-08-14, FR: 2025-08-14

Condition(s): Primary Aldosteronism defined by excess aldosterone secretion
Product: Baxdrostat, Baxdrostat, Baxdrostat Placebo

Primary endpoint: 1. Change from baseline in seated SBP at Week 8, 2. Normalization of the Renin Angiotensin Aldosterone system (RAAS) at Week 8
Endpoint(s): Percent change from RWD baseline (Week 44) in DRC at Week 52, Change from RWD baseline (Week 44) in seated SBP at Week 52, Achieving normalisation of the Renin Angiotensin Aldosterone System (RAAS) at week 8, Achieving serum potassium ≥ 3.7 mmol/L without potassium supplementation at Week 8 in participants with serum potassium < 3.7 mmol/L or potassium supplementation at baseline, Achieving 24-hour urine aldosterone < 10 μg at Week 8 in participants with 24-hour urine aldosterone ≥ 10 μg at baseline, Percent change from baseline in 24-hour urine albumin at Week 8

Source: https://euclinicaltrials.eu/ctis-public/view/2025-520740-16-00